EU clinical trial 2022-502705-15-00: A Phase III, Double-blind, Multicenter, Randomized study of Atezolizumab (anti-PD‑L1 antibody) versus Placebo as Adjuvant therapy in Patients with High-Risk Muscle-Invasive Bladder Cancer who are CTDNA positive following cystectomy
Protocol code: BO42843
Sponsor: F. Hoffmann-La Roche AG (Pharmaceutical company). Phase: Therapeutic confirmatory (Phase III). Countries: Germany (ongoing, recruitment ended), Greece (ongoing, recruitment ended), Ireland (ongoing, recruitment ended), Spain (ongoing, recruitment ended), Poland (ongoing, recruitment ended), Czechia (ongoing, recruitment ended), Italy (ongoing, recruitment ended), France (ongoing, recruitment ended), Belgium (ongoing, recruitment ended).
Therapeutic area(s): Diseases [C] - Neoplasms [C04]
Gender: Female, Male. Age: 18-64 years, 65+ years. Enrolment: 112.
Status: Ongoing, recruitment ended. Start date (EU): 2021-03-08. Decision date: 2024-02-07. Results received: No. Last updated: 2026-06-05.
Decision dates by country: IT: 2024-02-08, PL: 2024-02-08, CZ: 2024-02-07, FR: 2024-02-12, BE: 2024-02-09, ES: 2024-02-07, IE: 2024-02-07, GR: 2024-03-20, DE: 2024-02-08

Condition(s): High-risk muscle-invasive bladder cancer
Product: Tecentriq concentrate for solution for infusion placebo 0mg, Tecentriq 840 mg concentrate for solution for infusion

Primary endpoint: 1.Investigator assessed DFS in patients who are ctDNA-positive within 24 weeks of cystectomy (primary analysis population)
Endpoint(s): 1. OS in patients who are ctDNA-positive within 24 weeks after cystectomy (primary analysis population), 2. Investigator-assessed DFS in in patients who are ctDNA-positive at any time following cystectomy (all-randomized population), 3. IRF- assessed DFS in the primary analysis population, 4. IRF- assessed DFS in all-randomized patients, 5. Investigator-assessed DSS in the primary analysis population, 6. Investigator-assessed DMFS in the primary analysis population, 7. Time to deterioration of function and QoL in the primary analysis population and in the all-randomized population, 8. ctDNA clearance in the primary analysis population, 9. Incidence and severity of adverse events, with severity determined according to National Cancer Institute (NCI) Common Terminology Criteria for Adverse Events, Version 5.0 (NCI CTCAE v5.0), 10. Change from baseline in targeted vital signs, 11. Change from baseline in targeted clinical laboratory test results, 12. Serum concentration of atezolizumab at specified timepoints, 13. Incidence of anti-drug antibodies (ADAs) to atezolizumab during the study, 14. Prevalence of ADAs to atezolizumab at baseline

Source: https://euclinicaltrials.eu/ctis-public/view/2022-502705-15-00